EU clinical trial 2024-510924-38-00: IL-6 aGVHD Siltuximab: A phase II study to assess the efficacy and tolerability of siltuximab plus corticosteroids in first line treatment of grade III/IV acute graft versus host disease of the liver of/and the gastro-intestinal tract.
Sponsor: Universitair Medisch Centrum Groningen (Hospital/Clinic/Other health care facility). Phase: Therapeutic exploratory (Phase II). Countries: Netherlands (authorised, recruiting).
Therapeutic area(s): Diseases [C] - Immune System Diseases [C20]
Gender: Female, Male. Age: 18-64 years, 65+ years. Enrolment: 23.
Status: Authorised, recruiting. Start date (EU): 2025-11-19. Decision date: 2025-02-11. Results received: No. Last updated: 2025-02-11.

Condition(s): Grade III/IV acute graft versus host disease of the liver of/and the gastro-intestinal tract

Source: https://euclinicaltrials.eu/ctis-public/view/2024-510924-38-00